EU clinical trial 2024-518980-37-00: Phase I/II study with galunisertib combined with capecitabine in patients with advanced chemotherapy resistant colorectal cancer with peritoneal metastases
Protocol code: M22TGA
Sponsor: Het Nederlands Kanker Instituut-Antoni van Leeuwenhoek Ziekenhuis Stichting (Hospital/Clinic/Other health care facility). Phase: Phase I and Phase II (Integrated)- Other. Countries: Netherlands (ended).
Therapeutic area(s): Diseases [C] - Neoplasms [C04]
Gender: Female, Male. Age: 18-64 years, 65+ years. Enrolment: 31.
Status: Ended. Start date (EU): 2023-07-12. End date (EU): 2026-06-18. Decision date: 2025-01-23. Results received: No. Last updated: 2025-01-23.

Condition(s): colorectal cancer
Product: Capecitabine medac 150 mg film-coated tablets, LY2157299 80-150, Capecitabine medac 500 mg film-coated tablets

Primary endpoint: The primary aim of phase I of the current study is to determine safety and the RP2D of galunisertib plus capecitabine in patients with chemotherapy resistant CRC with PM. The primary aim of phase 2 is to determine the anti-tumor activity, as measured by ORR of galunisertib in combination with capecitabine in patients with chemotherapy resistant CRC with PM.
Endpoint(s): - To characterize the safety and tolerability of galunisertib in combination with chemotherapy regimens, as assessed by the incidence and severity of adverse events - To asses anti-tumor activity of galunisertib in combination with chemotherapy, as measured by DOR, TTR, PFS and OS (phase II only) - To determine the pharmacokinetic profile of galunisertib in combination with chemotherapy, as measured by plasma concentrations

Source: https://euclinicaltrials.eu/ctis-public/view/2024-518980-37-00